EU clinical trial 2024-518852-22-00: Study to Evaluate the Safety and Efficacy of Treatment with NLM-001 before Standard Chemotherapy plus Zalifrelimab in Patients with Advanced Pancreatic Cancer
Sponsor: Nelum Corp. (Pharmaceutical company). Phase: Human Pharmacology (Phase I)- Other. Countries: Spain (ended).
Therapeutic area(s): Diseases [C] - Neoplasms [C04]
Gender: Female, Male. Age: 18-64 years, 65+ years. Enrolment: 28.
Status: Ended. Start date (EU): 2021-09-03. End date (EU): 2025-04-28. Decision date: 2024-10-23. Results received: No. Last updated: 2025-05-23.

Condition(s): Advanced Pancreatic Cancer

Source: https://euclinicaltrials.eu/ctis-public/view/2024-518852-22-00